EU clinical trial 2022-500544-38-00: C4891001 - A Phase 3, Randomized, Open-Label, Multicenter Trial Of Arv-471 (PF-07850327) vs Fulvestrant In participants With Estrogen Receptor-Positive, HER2-Negative Advanced Breast Cancer Whose Disease Progressed After Prior Endocrine Based Treatment For Advanced Disease (VERITAC-2)
Protocol code: C4891001
Sponsor: Pfizer Inc. (Pharmaceutical company). Phase: Therapeutic confirmatory (Phase III). Countries: Hungary (ended), Spain (ongoing, recruitment ended), Austria (ended), Germany (ended), France (ongoing, recruitment ended), Czechia (ongoing, recruitment ended), Slovakia (ongoing, recruitment ended), Norway (ended), Belgium (ongoing, recruitment ended), Bulgaria (ongoing, recruitment ended), Finland (ended), Poland (ongoing, recruitment ended), Italy (ongoing, recruitment ended), Sweden (ended), Greece (ongoing, recruitment ended).
Therapeutic area(s): Diseases [C] - Neoplasms [C04]
Gender: Female, Male. Age: 18-64 years, 65+ years. Enrolment: 219.
Start date (EU): 2023-06-05. Decision date: 2023-05-03. Results received: No. Last updated: 2026-05-26.
Decision dates by country: NO: 2023-05-08, SE: 2023-05-04, HU: 2023-05-05, DE: 2023-05-08, AT: 2023-05-08, FI: 2023-05-16, SK: 2023-05-04, PL: 2023-05-23, BE: 2023-05-08, BG: 2023-05-09, CZ: 2023-05-25, GR: 2023-05-03, ES: 2023-05-03, FR: 2023-05-05, IT: 2023-05-16

Condition(s): Advanced Breast Cancer
Product: PF-07850327 round, Fulvestrant EVER Pharma, 250 mg/ 5 ml, roztwór do wstrzykiwań w ampułko-strzykawce, Fulvestrant EVER Pharma 250 mg Injektionslösung in einer Fertigspritze

Primary endpoint: PFS, defined as the time from the date of randomization to the date of first documented disease progression, as determined by BICR assessment per RECIST v1.1, or death due to any cause, whichever occurs first.
Endpoint(s): OS, defined as the time from the date of randomization to the date of death due to any cause., OR: confirmed CR or PR by BICR assessment • CBR defined as confirmed CR or PR at any time or SD or non-CR/non-PD ≥24 weeks by BICR assessment • DOR by BICR assessment, Type, incidence, severity (as graded by NCI CTCAE v5.0), seriousness and relationship to study medications of AEs and any laboratory and ECG abnormalities., QTc, EORTC QLQ-C30 • EORTC QLQ-BR23 • EuroQol; EQ-5D-5L • BPI-SF., Plasma concentrations of ARV-471 and its epimer ARV-473., ctDNA plasma quantitative changes from baseline to evaluate their associations with clinical outcomes.

Source: https://euclinicaltrials.eu/ctis-public/view/2022-500544-38-00